EU clinical trial 2024-518096-57-00: Efficacy and safety of adjunctive IgM-enriched immunoglobulin therapy with a personalized dose based on serum IgM-titers vs. standard dose in patients with septic shock. A multicenter, interventional, randomized, single-blinded, two arms, adaptive study design.
Sponsor: Azienda Ospedaliero Universitaria Di Modena (Hospital/Clinic/Other health care facility). Phase: Therapeutic confirmatory (Phase III). Countries: Italy (ongoing, recruiting).
Therapeutic area(s): Diseases [C] - Pathological Conditions, Signs and Symptoms [C23]
Gender: Female, Male. Age: 18-64 years, 65+ years. Enrolment: 356.
Status: Ongoing, recruiting. Start date (EU): 2024-11-11. Decision date: 2024-11-11. Results received: No. Last updated: 2025-04-04.

Condition(s): Septic shock
Product: Pentaglobin 50 mg/ml soluzione per infusione

Primary endpoint: All-cause mortality at day 28.
Endpoint(s): - All cause mortality at ICU discharge, hospital discharge at day90; - Occurrence of new organ dysfunction and grade of dysfunction during ICU stay; - IFHs day28; - HFD day90; - VFDs day 28; - VasoFDs at day28; - AFDs day28; - ICU acquired weakness at 7, 28 and 90days or hospital discharge defined by MRC Scale; - Occurrence of protocol related adverse events at day28.

Source: https://euclinicaltrials.eu/ctis-public/view/2024-518096-57-00